EU clinical trial 2024-511875-14-00: Predicting olaparib sensitivity in patients with unresectable locally advanced/metastatic HER2-negative breast cancer with BRCA1, BRCA2, PALB2, RAD51C or RAD51D mutations or RAD51-foci low test: RADIOLA TRIAL
Protocol code: SOLTI-1910
Sponsor: Solti Group (Pharmaceutical company). Phase: Therapeutic exploratory (Phase II). Countries: Spain (ended).
Therapeutic area(s): Diseases [C] - Neoplasms [C04]
Gender: Female, Male. Age: 18-64 years, 65+ years. Enrolment: 63.
Status: Ended. Start date (EU): 2022-03-24. End date (EU): 2025-02-27. Decision date: 2024-06-03. Results received: Yes. Last updated: 2024-06-03.

Condition(s): Pre and post-menopausal women and men with unresectable locally advanced or metastatic triple negative breast cancer (TNBC) or ET ±CDK4/6-resistant hormonal receptor positive and HER2-negative (HR+/HER2-) breast cancer
Product: Lynparza 150 mg film-coated tablets, Lynparza 100 mg film-coated tablets

Primary endpoint: Overall response rate (ORR) defined as the proportion of patients with best overall response of complete response or partial response , as per local investigator´s assessment and according to Response Evaluation Criteria in Solid Tumours (RECIST) version 1.1 criteria in both RAD51- foci low tumours and RAD51-foci high tumours.
Endpoint(s): Progression free survival (PFS) defined as the time from allocation to the first occurrence of disease progression, as determined locally by the investigator using RECIST v.1.1, or death from any cause, whichever occurs first, Clinical Benefit Rate (CBR) defined as the proportion of patients with a best overall response of complete response (CR), partial response (PR) or Stable Disease (SD) lasting ≥ 24 weeks, based on local investigator´s assessment according to RECIST v1.1., Duration of response (DoR) defined as the time from the first occurrence of a documented objective response to disease progression, as determined locally by the investigator through use of RECIST v.1.1, or death from any cause, whichever occurs first., Time to response (TtR) defined as the time from allocation to the first objective tumour response (tumour shrinkage of ≥30%) observed for patients who achieved a CR or PR., PFS on study treatment compared to PFS on prior line of therapy (pre-PFS)., Overall response rate, Progression free survival, Clinical benefit rate, Duration of response, PFS on study treatment compared to PFS on prior line of therapy (pre-PFS)., Overall response rate, Progression free survival, Clinical benefit rate, Duration of response, PFS on study treatment compared to PFS on prior line of therapy (pre-PFS)., Overall response rate, Progression free survival, Clinical benefit rate, Duration of response, Incidence, duration and severity of Adverse Events (AEs) assessed by the NCI Common Terminology for Classification of Adverse Events (CTCAE) version 5, including dose reductions, delays and treatment discontinuations.

Source: https://euclinicaltrials.eu/ctis-public/view/2024-511875-14-00